EU clinical trial 2024-515264-31-00: A randomised, multi-centre, intra-patient imaging and dosimetry crossover study of lutetium (177Lu) rhPSMA-10.1 and lutetium (177Lu) vipivotide tetraxetan (Pluvicto®) in patients with non-curative metastatic prostate cancer
Protocol code: BET-PSMA-001
Sponsor: Blue Earth Therapeutics Limited (Pharmaceutical company). Phase: Human Pharmacology (Phase I)- Other. Countries: Spain (ended), Germany (ended), France (ended), Netherlands (ended).
Therapeutic area(s): Diseases [C] - Neoplasms [C04]
Gender: Male. Age: 18-64 years, 65+ years. Enrolment: 18.
Status: Ended. Start date (EU): 2025-04-15. End date (EU): 2025-08-14. End date: 2025-08-15. Decision date: 2025-03-03. Results received: No. Last updated: 2025-06-13.
Decision dates by country: FR: 2025-03-03, DE: 2025-03-04, ES: 2025-03-05, NL: 2025-03-07

Condition(s): PSMA-positive non-curative metastatic castration-resistant prostate cancer
Product: Pluvicto 1 000 MBq/mL solution for injection/infusion, Lutetium (177Lu) rhPSMA-10.1 injection

Primary endpoint: 1. The primary endpoint of the study is the ratio of tumour to kidney absorbed dose ratios (i.e. the ratio of the therapeutic indices).
Endpoint(s): 1. The absorbed dose delivered to the tumours for lutetium (177Lu) rhPSMA-10.1 compared with lutetium (177Lu) vipivotide tetraxetan., 2. The ratio of tumour to normal organ absorbed dose ratios. Organs of interest include the salivary glands and bone marrow., 3. Tumour retention of lutetium (177Lu) rhPSMA-10.1 compared with lutetium (177Lu) vipivotide tetraxetan. Note: Retention will be measured as the tumour effective half-life., 4. Normal organ retention of lutetium (177Lu) rhPSMA-10.1 compared with lutetium (177Lu) vipivotide tetraxetan. Note: Retention will be measured as the normal organ effective half-life., 5. Frequency and nature of treatment-emergent adverse events (TEAEs).

Source: https://euclinicaltrials.eu/ctis-public/view/2024-515264-31-00